EU clinical trial 2023-509744-10-00: iMagIng pulmonaRy Aspergillosis using Gallium-68-dEferoxamine (MIRAGE)
Protocol code: 115136
Sponsor: Radboud universitair medisch centrum Stichting (Hospital/Clinic/Other health care facility). Phase: Therapeutic exploratory (Phase II). Countries: Netherlands (ongoing, recruiting).
Therapeutic area(s): Analytical, Diagnostic and Therapeutic Techniques and Equipment [E] - Diagnosis [E01]; Diseases [C] - Respiratory Tract Diseases [C08]; Diseases [C] - Bacterial Infections and Mycoses [C01]
Gender: Female, Male. Age: 18-64 years, 65+ years. Enrolment: 10.
Status: Ongoing, recruiting. Start date (EU): 2025-04-01. Decision date: 2024-04-18. Results received: No. Last updated: 2026-04-13.

Condition(s): Pulmonary aspergillosis
Product: DEFEROXAMINE, GALLIUM (68GA) CHLORIDE

Primary endpoint: Quantitative uptake and target-to-background ratios of [68Ga]Ga-DFO-B in suspected aspergillus lesions in patients with pulmonary aspergillosis.
Endpoint(s): [68Ga]Ga-DFO-B uptake patterns in the different forms of pulmonary aspergillosis., [68Ga]Ga-DFO-B uptake patterns in patients with and without co-infections., [68Ga]Ga-DFO-B uptake patterns compared to the human iron status including serum iron, transferrin, transferrin saturation, and ferritin., Cell-bound and free fraction of [68Ga]Ga-DFO-B., [68Ga]Ga-DFO-B uptake patterns and cell-bound and free fraction of [68Ga]Ga-DFO-B compared to the number of neutrophils, eosinophils, monocytes, and lymphocytes.

Source: https://euclinicaltrials.eu/ctis-public/view/2023-509744-10-00